EU clinical trial 2023-503908-87-00: Plethysmography with acetylcholin and carbacholin – A clinical method study
Sponsor: Regionshospitalet Godstrup (Hospital/Clinic/Other health care facility). Phase: Therapeutic exploratory (Phase II). Countries: Denmark (ended).
Therapeutic area(s): Phenomena and Processes [G] - Circulatory and Respiratory Physiological Phenomena [G09]; Diseases [C] - Cardiovascular Diseases [C14]
Gender: Female, Male. Age: 18-64 years. Enrolment: 1.
Status: Ended. Start date (EU): 2023-06-02. End date (EU): 2023-08-17. Decision date: 2023-05-25. Results received: Yes. Last updated: 2023-05-26.

Condition(s): Vascular dysfunction
Product: MIOSTAT 0,01 % intraokulare Injektionslösung, Miochol®-E, 20mg, Powder and Solvent for instillation solution for intraocular use

Primary endpoint: Relative and absolute forearm blood flow (FBF)

Source: https://euclinicaltrials.eu/ctis-public/view/2023-503908-87-00